EU clinical trial 2023-503757-35-00: A multicenter, single-arm, open-label study to assess the pharmacokinetics, safety, and tolerability of cefiderocol in hospitalized pediatric patients from birth to < 3 months of age with suspected or confirmed aerobic Gram-negative bacterial infections
Protocol code: 1904R2136
Sponsor: Shionogi B.V. (Pharmaceutical company). Phase: Therapeutic exploratory (Phase II). Countries: Spain (not authorised), Greece (not authorised), Bulgaria (not authorised).
Therapeutic area(s): Diseases [C] - Bacterial Infections and Mycoses [C01]
Gender: Female, Male. Age: 0-17 years. Enrolment: 20.
Status: Not authorised. Decision date: 2023-10-30. Results received: No. Last updated: 2023-10-30.
Decision dates by country: BG: 2023-10-30, GR: 2023-10-30, ES: 2023-10-30

Condition(s): Aerobic Gram-negative bacterial infections
Product: Fetcroja 1 g powder for concentrate for solution for infusion

Primary endpoint: Cmax, AUC0-inf, and t1/2 after single dose, Cmax, AUC0-τ, and t1/2 after a minimum of 4 doses of cefiderocol
Endpoint(s): Adverse events, Vital signs, Physical examinations, Clinical laboratory assessments, Death

Source: https://euclinicaltrials.eu/ctis-public/view/2023-503757-35-00